EU clinical trial 2023-506053-38-00: A first-in-human, open-label, dose escalation trial with expansion cohorts to evaluate the safety and preliminary efficacy of BNT314 as monotherapy in patients with advanced malignant solid tumors
Protocol code: BNT314-01
Sponsor: BioNTech SE (Pharmaceutical company). Phase: Human Pharmacology (Phase I)- First administration to humans. Countries: Denmark (ongoing, recruitment ended), Spain (ongoing, recruitment ended), Belgium (ongoing, recruitment ended).
Therapeutic area(s): Diseases [C] - Neoplasms [C04]
Gender: Female, Male. Age: 18-64 years, 65+ years. Enrolment: 43.
Status: Ongoing, recruitment ended. Start date (EU): 2024-08-27. Decision date: 2024-04-12. Results received: No. Last updated: 2026-02-13.
Decision dates by country: BE: 2024-04-17, ES: 2024-04-12, DK: 2024-04-12

Condition(s): Advanced or metastatic malignant solid tumors
Product: BNT314

Primary endpoint: Dose escalation only: In patients receiving at least one dose of BNT314 and evaluable for DLT: Occurrence of DLTs within a cohort during the DLT evaluation period., In patients receiving at least one dose of BNT314, from first dose of trial treatment to 90 days after last dose of trial treatment, per cohort, number, and proportion of patients with: Occurrence of treatment-emergent adverse events (TEAEs) including Grade ≥ 3, serious, fatal TEAE by relationship., In patients receiving at least one dose of BNT314, from first dose of trial treatment to 90 days after last dose of trial treatment, per cohort, number, and proportion of patients with: Occurrence of dose reduction and discontinuation of IMP due to TEAE., In patients receiving at least one dose of BNT314, from first dose of trial treatment to 90 days after last dose of trial treatment, per cohort, number, and proportion of patients with: Occurrence of Grade≥3 abnormal safety laboratory parameters.
Endpoint(s): In patients receiving at least one dose of BNT314 and evaluable for PK, per cohort, geometric means for the following PK parameters: Area under the concentration-time curve from pre-dose to last quantifiable time point prior to the next dose (AUClast) and from pre-dose to the end of the dosing period (AUCtau)., In patients receiving at least one dose of BNT314 and evaluable for PK, per cohort, geometric means for the following PK parameters: Maximum concentration (Cmax) from pre-dose to the end of the dosing period., In patients receiving at least one dose of BNT314, per cohort, number and proportion of patients who developed detectable anti-drug antibody (ADA) from baseline to the end of trial treatment., In patients receiving at least one dose of BNT314: Disease control rate (DCR) based on investigator’s tumor assessment according to RECIST 1.1 is reported with number and proportion of patients with a complete response (CR), partial response (PR), or stable disease (SD) (assessed at least 6 weeks after first dose of trial treatment) as best overall response., In patients receiving at least one dose of BNT314: Objective response rate (ORR) based on investigator’s tumor assessment according to RECIST 1.1 is reported with number and proportion of patients with a confirmed CR or PR as best overall response., In patients receiving at least one dose of BNT314: In patients with confirmed CR or PR assessment, duration of response (DOR) based on investigator’s tumor assessment according to RECIST 1.1 is defined as the time from first objective response (CR or PR) to first occurrence of objective tumor progression or death from any cause, whichever occurs first.

Source: https://euclinicaltrials.eu/ctis-public/view/2023-506053-38-00